EU clinical trial 2024-515617-18-00: A Dose-Escalation and Expansion Study of the Safety and Pharmacokinetics of XL092 as Single-Agent and Combination Therapy in Subjects with Inoperable Locally Advanced or Metastatic Solid Tumors
Protocol code: XL092-001
Sponsor: Exelixis Inc. (Pharmaceutical company). Phase: Human Pharmacology (Phase I)- First administration to humans. Countries: Czechia (ongoing, recruitment ended), Spain (ongoing, recruitment ended), Belgium (ended), France (ongoing, recruitment ended), Germany (ended).
Therapeutic area(s): Diseases [C] - Neoplasms [C04]
Gender: Female, Male. Age: 18-64 years, 65+ years. Enrolment: 140.
Start date (EU): 2022-02-14. Decision date: 2024-09-11. Results received: No. Last updated: 2026-03-17.
Decision dates by country: BE: 2024-09-12, CZ: 2024-09-11, DE: 2024-09-12, FR: 2024-09-12, ES: 2024-09-12

Condition(s): Advanced clear cell renal cell carcinoma (ccRCC), non-clear cell renal cell carcinoma (nccRCC), hormone receptor-positive breast cancer (HR+ BC), metastatic castration-resistant prostate cancer (mCRPC), colorectal cancer (CRC)

Source: https://euclinicaltrials.eu/ctis-public/view/2024-515617-18-00